EU clinical trial 2024-516309-21-00: Pharmacology of nasal applied mupirocin in healthy volunteers: single-centre study. MUPIPHARM STUDY
Sponsor: Centre Hospitalier Universitaire De Saint Etienne (Hospital/Clinic/Other health care facility). Phase: Human Pharmacology (Phase I)- Other. Countries: France (ended).
Therapeutic area(s): Diseases [C] - Bacterial Infections and Mycoses [C01]
Gender: Female, Male. Age: 18-64 years, 65+ years. Enrolment: 60.
Status: Ended. End date (EU): 2025-10-30. Decision date: 2024-08-30. Results received: No. Last updated: 2024-11-22.

Condition(s): healthy volunteer

Source: https://euclinicaltrials.eu/ctis-public/view/2024-516309-21-00